EU clinical trial 2024-519157-10-00: A Study to Assess Adverse Events, How the Drug Moves Through the Body and Effectiveness of Intravenous Infusions of ABBV-319 in Adult Participants with Systemic Lupus Erythematosus (SLE) and Sjogren's Disease (SjD)
Protocol code: M25-433
Sponsor: AbbVie Deutschland GmbH & Co. KG (Pharmaceutical company). Phase: Human Pharmacology (Phase I)- Other. Countries: Netherlands (authorised, recruiting), France (authorised, recruiting).
Therapeutic area(s): Phenomena and Processes [G] - Immune system processes [G12]
Gender: Female, Male. Age: 18-64 years, 65+ years. Enrolment: 18.
Status: Authorised, recruiting. Start date (EU): 2025-11-24. Decision date: 2025-08-28. Results received: No. Last updated: 2026-04-28.
Decision dates by country: NL: 2025-08-28, FR: 2025-08-29

Condition(s): Systemic Lupus Erythematosus, Sjogren's disease

Source: https://euclinicaltrials.eu/ctis-public/view/2024-519157-10-00